EU clinical trial 2024-519348-34-00: [177Lu]Lu-PSMAI&T radioligand therapy (PSMA-RLT) for patients with prostate cancer and biochemical but not radio-morphological local recurrence after primary therapy with curative intent: A Prospective Phase II Pilot Study
Sponsor: Medical University Of Vienna (Educational Institution). Phase: Therapeutic exploratory (Phase II). Countries: Austria (ongoing, recruiting).
Therapeutic area(s): Diseases [C] - Neoplasms [C04]
Gender: Male. Age: 18-64 years, 65+ years. Enrolment: 26.
Status: Ongoing, recruiting. Start date (EU): 2024-12-09. Decision date: 2024-12-09. Results received: No. Last updated: 2026-05-22.

Condition(s): prostate carcinoma
Product: Locametz 25 micrograms kit for radiopharmaceutical preparation, TECEOS Trockenstechampullen

Primary endpoint: PSA response in term of PSA decline of ≥ 50% from baseline value. • Emerge therapy toxicity in terms of pathological reduction of values of blood count, kidney and liver functions from baseline levels assessed by CTCAE (v5.0).

Source: https://euclinicaltrials.eu/ctis-public/view/2024-519348-34-00